EU clinical trial 2023-505423-31-00: A Phase 3, Multicenter, Open-label, Randomized Study to Compare the Efficacy and Safety of MK-2870 Versus Treatment of Physician’s Choice in 3L+ Advanced/Metastatic Gastroesophageal Adenocarcinoma (Gastric Adenocarcinoma, Gastroesophageal Junction Adenocarcinoma, and Esophageal Adenocarcinoma)
Protocol code: MK-2870-015
Sponsor: Merck Sharp & Dohme LLC (Pharmaceutical company). Phase: Therapeutic confirmatory (Phase III). Countries: Belgium (ongoing, recruitment ended), Germany (ongoing, recruitment ended), Italy (ongoing, recruitment ended), Spain (ongoing, recruitment ended), Poland (ongoing, recruitment ended), Denmark (ongoing, recruitment ended), France (ongoing, recruitment ended).
Therapeutic area(s): Diseases [C] - Neoplasms [C04]
Gender: Female, Male. Age: 18-64 years, 65+ years. Enrolment: 136.
Status: Ongoing, recruitment ended. Start date (EU): 2024-08-08. Decision date: 2024-05-29. Results received: No. Last updated: 2026-06-18.
Decision dates by country: FR: 2024-06-03, BE: 2024-05-30, DE: 2024-05-29, PL: 2024-06-03, DK: 2024-05-29, IT: 2024-06-03, ES: 2024-05-29

Condition(s): advanced or metastatic gastric adenocarcinoma, gastroesophageal junction adenocarcinoma, or esophageal adenocarcinoma
Product: MK-2870, TRIFLURIDINE, COMBINATIONS, IRINOTECAN, PACLITAXEL, DOCETAXEL, PARACETAMOL

Primary endpoint: Overall Survival (OS)
Endpoint(s): Progression-free Survival (PFS), Objective Response Rate (ORR), Duration of Response (DOR), Number of Participants Who Experience an Adverse Event (AE), Number of Participants Who Discontinue Study Intervention Due to an AE

Source: https://euclinicaltrials.eu/ctis-public/view/2023-505423-31-00